EU clinical trial 2024-518502-40-00: A Phase 1/2, Dose-finding Study Investigating the Safety and Efficacy of Pirtobrutinib in Adults with Immune Thrombocytopenia
Protocol code: J2N-MC-JZNZ
Sponsor: Eli Lilly & Co. (Pharmaceutical company). Phase: Phase I and Phase II (Integrated)- Other. Countries: France (authorised, recruiting), Italy (authorised, recruiting), Denmark (authorised, recruiting), Spain (ongoing, recruiting), Poland (ongoing, recruiting), Norway (authorised, recruitment pending).
Therapeutic area(s): Diseases [C] - Immune System Diseases [C20]
Gender: Female, Male. Age: 18-64 years. Enrolment: 30.
Start date (EU): 2025-07-28. Decision date: 2025-06-23. Results received: No. Last updated: 2025-12-12.
Decision dates by country: FR: 2025-06-25, NO: 2025-12-12, IT: 2025-06-25, PL: 2025-06-30, ES: 2025-06-27, DK: 2025-06-23

Condition(s): Immune Thrombocytopenia
Product: Pirtobrutinib, Placebo tablets

Primary endpoint: Phase 1: DLTs, Phase 1: Other safety endpoints, including, but not limited to, TEAEs, SAEs, clinical laboratory tests, vital signs, and ECGs, Phase 2: Stable platelet response rate is defined as the proportion of participants achieving platelet count of ≥50 k/μL on at least 4 of the 6 consecutive biweekly visits between Weeks 14 and 24 in the absence of rescue therapy and prohibited concomitant medication that may impact efficacy
Endpoint(s): Phase 1: Platelet response rate defined as proportion of participants who achieve at least 2 consecutive platelet counts of ≥50 k/μL and an increase from baseline of ≥20 k/μL to any time during treatment without the use of rescue medication or prohibited concomitant medication that may impact efficacy within 4 weeks prior to the latest elevated platelet count, Phase 1: Number of cumulative weeks with platelet counts ≥50 k/μL by Week 12, Phase 1: Plasma concentrations of pirtobrutinib, Phase 2: Platelet response rate is defined as the proportion of participants with ≥2 consecutive platelet counts ≥50 k/μL and an increase of platelet count of ≥20 k/μL from baseline to any time during treatment or follow-up without the use of rescue medication or prohibited concomitant medication that may impact efficacy within 4 weeks prior to the latest elevated platelet count, Phase 2: Number of cumulative weeks with platelet counts ≥50 k/μL and ≥100 k/μL, Phase 2: Proportion of participants requiring rescue therapy, Phase 2: Summary of safety data, including but not limited to the number and incidence of TEAEs, SAEs, and discontinuations due to AEs, Phase 2: Plasma concentrations of pirtobrutinib

Source: https://euclinicaltrials.eu/ctis-public/view/2024-518502-40-00